EU clinical trial 2024-514195-40-00: A Phase 1/2, Multicenter, Open-label Study of IMGN632 Monotherapy Administered Intravenously in Patients with CD123-positive Acute Myeloid Leukemia and Other CD123-positive Hematologic Malignancies
Sponsor: AbbVie Deutschland GmbH & Co. KG (Pharmaceutical company). Phase: Phase I and Phase II (Integrated)- First administration to humans. Countries: Spain (ended), France (ongoing, recruitment ended).
Therapeutic area(s): Diseases [C] - Neoplasms [C04]
Gender: Female, Male. Age: 18-64 years, 65+ years. Enrolment: 34.
Start date (EU): 2019-02-28. Decision date: 2024-07-05. Results received: No. Last updated: 2026-01-19.
Decision dates by country: FR: 2024-07-05, ES: 2024-07-08

Condition(s): Acute Myeloid Leukemia and other blood cancers
Product: PIVEKIMAB SUNIRINE

Primary endpoint: Escalation Phase: MTD and RP2D, BPDCN: CR+clinical CR [CRc]
Endpoint(s): Treatment-emergent adverse events (TEAEs), serious adverse events (SAEs), and DLTs, PK parameters, including but not limited to observed maximum concentration (Cmax) and area under the concentration versus time curve (AUC), To evaluate the potential immunogenecity of IMGN632 - ADA, Overall response rate (OOR) (CR without minimal residual disease [CRMRD- ] + CR + complete remission with partial hematologic recovery [CRh] + complete remission with incomplete recovery [CRi] + morphologic leukemia-free state [MLFS] + partial response [PR]), complete remission rate (CRMRD-, CR, CRh), composite complete remission (CCR) rate (CRMRD-, CR, CRh, CRi), and time to event outcomes (duration of overall response [DOR], event-free survival, relapse-free survival, OS)., BPDCN Expansion Phase (Cohorts 1 and 6): CR+CRc, BPDCN Expansion Phase (Cohorts 1 and 6): ADA, BPDCN Expansion Phase (Cohorts 1 and 6): Conversion rate to independence of red blood cell and platelet transfusion relative to baseline

Source: https://euclinicaltrials.eu/ctis-public/view/2024-514195-40-00